EU clinical trial 2023-503807-27-00: PRODIGE 76-IMMUNOBILADJ: Capecitabine plus durvalumab or capecitabine alone as adjuvant therapy in patients with resected biliary tract carcinoma. A non-comparative randomized phase II study
Sponsor: Fondation Franc.Cancerologie Digestive (Hospital/Clinic/Other health care facility). Phase: Therapeutic exploratory (Phase II). Countries: France (ended).
Therapeutic area(s): Phenomena and Processes [G] - Immune system processes [G12]; Diseases [C] - Digestive System Diseases [C06]
Gender: Female, Male. Age: 18-64 years, 65+ years. Enrolment: 219.
Status: Ended. End date (EU): 2023-08-29. Decision date: 2023-07-07. Results received: Yes. Last updated: 2023-07-07.

Condition(s): Biliary tract carcinoma
Product: IMFINZI 50 mg/mL concentrate for solution for infusion., Capecitabine Accord 150 mg film-coated tablets, Capecitabine Accord 300 mg film-coated tablets, Capecitabine Accord 500 mg film-coated tablets

Primary endpoint: Disease-Free Survival rate at 18 months
Endpoint(s): Safety profile in two arms, DFS in two arms, overall survival in two arms, health-related Quality of life in the two arms, Prognostic and predictive biomarkers in terms of survival

Source: https://euclinicaltrials.eu/ctis-public/view/2023-503807-27-00